EU clinical trial 2025-521455-23-00: Evaluation of safety, side effects and how the drug CHF6467 administrated via intranasal route is absorbed, modified and removed in healthy subjects.
Protocol code: CLI-06467AC1-02
Sponsor: Chiesi Farmaceutici S.p.A. (Pharmaceutical company). Phase: Human Pharmacology (Phase I)- Other. Countries: Bulgaria (ongoing, recruiting).
Therapeutic area(s): Diseases [C] - Congenital, Hereditary, and Neonatal Diseases and Abnormalities [C16]
Gender: Female, Male. Age: 18-64 years. Enrolment: 68.
Status: Ongoing, recruiting. Start date (EU): 2025-09-11. Decision date: 2025-08-05. Results received: No. Last updated: 2026-07-22.

Condition(s): Neonatal Hypoxic-Ischemic Encephalopathy (HIE), Neonatal Hypoxic-Ischemic Encephalopathy (HIE)

Source: https://euclinicaltrials.eu/ctis-public/view/2025-521455-23-00